EU clinical trial 2024-515384-62-00: Interest of peri operative CHemotherapy In patients with CINSARC high-risk localized Soft Tissue Sarcoma
Protocol code: 19SARC05
Sponsor: Oncopole Claudius Regaud (Hospital/Clinic/Other health care facility). Phase: Therapeutic confirmatory (Phase III). Countries: France (ongoing, recruiting).
Therapeutic area(s): Diseases [C] - Neoplasms [C04]
Gender: Female, Male. Age: 18-64 years, 65+ years. Enrolment: 600.
Status: Ongoing, recruiting. Start date (EU): 2020-10-09. Decision date: 2024-06-27. Results received: No. Last updated: 2026-04-02.
Decision dates by country: FR: 2024-08-30

Condition(s): Soft Tissue Sarcoma
Product: HOLOXAN 2000 mg, poudre pour usage parentéral, DOXORUBICINE TEVA 50 mg/25 ml, solution injectable, Dacarbazine medac 500 mg, poudre pour solution pour perfusion

Primary endpoint: The primary endpoint is Metastasis-free survival (MFS). MFS is defined by the delay between randomization and the appearance of metastatic disease or death from any cause.
Endpoint(s): Disease-free survival (DFS) is defined by the delay between randomization and first relapse (local, regional, or distant) or death from any cause. Patients still alive at the time of analysis (including lost to follow-up) without appearance of relapse will be censored at the last disease assessment date., Overall survival (OS) is defined by the delay between randomization and death from any cause. Patients still alive at the time of analysis (including lost to follow-up) will be censored at the last known alive date., Safety will be assessed by the toxicity grading of the National Cancer Institute (NCI-CTCAE v5.0).

Source: https://euclinicaltrials.eu/ctis-public/view/2024-515384-62-00